EU clinical trial 2023-503404-89-00: A study to evaluate the Safety, Pharmacokinetics, and Activity of Subcutaneous Cevostamab (BFCR4350A) in Patients with Relapsed or Refractory Multiple Myeloma (CAMMA 3)
Protocol code: GO43227
Sponsor: Genentech Inc. (Pharmaceutical company). Phase: Human Pharmacology (Phase I)- Other. Countries: Belgium (ongoing, recruiting), Italy (ongoing, recruiting), Greece (ongoing, recruiting).
Therapeutic area(s): Diseases [C] - Neoplasms [C04]
Gender: Female, Male. Age: 18-64 years, 65+ years. Enrolment: 45.
Status: Ongoing, recruiting. Start date (EU): 2021-12-08. Decision date: 2024-07-30. Results received: No. Last updated: 2026-03-30.
Decision dates by country: BE: 2024-07-30, GR: 2024-10-11, IT: 2024-08-05

Condition(s): Relapsed or Refractory Multiple Myeloma R/R MM

Source: https://euclinicaltrials.eu/ctis-public/view/2023-503404-89-00